EU clinical trial 2022-502126-40-00: A Phase 3 Open-label Clinical Study of Doravirine/Islatravir (DOR/ISL [100 mg/0.25 mg]) Once Daily for the Treatment of HIV-1 Infection in Participants Who Previously Received DOR/ISL (100 mg/0.75 mg) QD in a Phase 3 Clinical Study
Protocol code: MK-8591A-054
Sponsor: Merck Sharp & Dohme LLC (Pharmaceutical company). Phase: Therapeutic confirmatory (Phase III). Countries: France (not authorised), Germany (not authorised), Spain (not authorised), Italy (not authorised), Finland (not authorised), Poland (not authorised).
Therapeutic area(s): Diseases [C] - Virus Diseases [C02]
Gender: Female, Male. Age: 18-64 years, 65+ years. Enrolment: 356.
Status: Not authorised. Decision date: 2023-04-28. Results received: No. Last updated: 2023-05-02.
Decision dates by country: FI: 2023-05-02, FR: 2023-04-29, DE: 2023-05-02, IT: 2023-05-02, ES: 2023-04-28, PL: 2023-05-02

Condition(s): HIV-1 infection

Primary endpoint: Percentage of participants with one or more adverse events, Percentage of participants who discontinue study intervention due to adverse events
Endpoint(s): Percentage of participants with human immunodeficiency virus-1 (HIV-1) ribonucleic acid (RNA) <50 copies/mL at Week 96, Percentage of participants with HIV-1 RNA ≥50 copies/mL at Week 96, Percentage of participants with HIV-1 RNA ≥200 copies/mL at Week 96, Percentage of participants with evidence of viral drug resistance-associated substitutions

Source: https://euclinicaltrials.eu/ctis-public/view/2022-502126-40-00